EU clinical trial 2022-502339-20-00: EORTC 2120-HNCG: Radiotherapy plus xevinapant or placebo in older patients with locally advanced head and neck squamous cell carcinoma: a randomized phase II study (Ravina)
Protocol code: EORTC 2120-HNCG
Sponsor: European Organisation For Research And Treatment Of Cancer (Patient organisation/association). Phase: Therapeutic exploratory (Phase II). Countries: Italy (ended), Slovenia (ended), Germany (ended), Netherlands (ended), Belgium (ended), Norway (ended), Spain (ended), France (ended), Ireland (ended).
Therapeutic area(s): Diseases [C] - Otorhinolaryngologic Diseases [C09]; Analytical, Diagnostic and Therapeutic Techniques and Equipment [E] - Therapeutics [E02]
Gender: Female, Male. Age: 65+ years. Enrolment: 225.
Status: Ended. Start date (EU): 2023-11-15. End date (EU): 2025-06-11. Decision date: 2023-07-25. Results received: Yes. Last updated: 2023-12-21.
Decision dates by country: BE: 2023-07-27, DE: 2023-07-27, NL: 2023-07-25, SI: 2023-07-27, ES: 2023-07-26, FR: 2023-07-27, IE: 2023-12-21, NO: 2023-12-08, IT: 2023-07-26

Condition(s): Squamous cell carcinoma of head and neck
Product: Xevinapant placebo, xevinapant

Primary endpoint: The primary endpoint is locoregional event-free survival (LREFS) as assessed by the local investigator. Events are defined as locoregional progression, recurrence of locoregional disease, new SCC of the head and neck in the radiation field and death from any cause.
Endpoint(s): Response to treatment according to RECIST 1.1, Progression Free Survival as assessed by the local investigator., Overall Survival, Safety according to the CTCAE (NCI Common Terminology Criteria for Adverse Events) Version 5.0 for toxicity and Serious Adverse Event reporting, Patient-reported HRQoL as assessed by global health/QoL and physical functioning scales from the EORTC QLQ-C30 at week 20. The fatigue scale from the QLQ-C30, and pain in the head and neck scale from IL225 will be assessed to provide additional insight into the treatment effects for the global health/QOL scale (QLQ-C30) and the physical functioning scales

Source: https://euclinicaltrials.eu/ctis-public/view/2022-502339-20-00